EU clinical trial 2024-520189-67-00: VALIDATION OF THE SENTINEL LYMPH NODE TECHNIQUE IN EARLY-STAGE OVARIAN CANCER (SENTOV II)
Protocol code: SENTOV II
Sponsor: IIS La Fe (Laboratory/Research/Testing facility). Phase: Therapeutic confirmatory (Phase III). Countries: Spain (ongoing, recruiting).
Therapeutic area(s): Analytical,Diagnostic,Therapeutic Techniques and Equipment [E]-Surgical Procedures, Operative [E04]; Diseases [C] - Female Urogenital Diseases and Pregnancy Complications [C13]; Phenomena and Processes [G] - Reproductive and Urinary Physiological Phenomena [G08]
Gender: Female. Age: 18-64 years, 65+ years. Enrolment: 200.
Status: Ongoing, recruiting. Start date (EU): 2025-10-08. Decision date: 2025-07-22. Results received: No. Last updated: 2026-08-03.

Condition(s): OVARIAN CANCER
Product: PERTECHNETATE (99MTC) SODIUM, INDOCYANINE GREEN, HUMAN SERUM ALBUMIN

Primary endpoint: Negative predictive value of the sentinel lymph node technique.
Endpoint(s): Tumor size., Tumor location., Injection site., Type of tracer used., Injection-detection interval., Detection method., Anatomical location of the sentinel node., Number of detected sentinel lymph nodes., Number of detected lymph nodes., Histological type of detected sentinel lymph nodes., Degree of differentiation of detected sentinel lymph nodes., Lymphovascular invasion of detected sentinel lymph nodes., Ultrastaging of detected sentinel lymph nodes., Binary classification of detected sentinel lymph nodes., Histological result of detected sentinel lymph nodes., FIGO stage of detected sentinel lymph nodes., Surgical procedure performed., Intraoperative complications.

Source: https://euclinicaltrials.eu/ctis-public/view/2024-520189-67-00